EU clinical trial 2024-518100-45-00: COLchicine to mitigate accelerated Atherosclerosis induced by immune checkpoint inhibitors in patients with cancer: the COLA trial
Sponsor: Amsterdam UMC Stichting (Patient organisation/association). Phase: Therapeutic confirmatory (Phase III). Countries: Netherlands (authorised, recruitment pending).
Therapeutic area(s): Diseases [C] - Cardiovascular Diseases [C14]
Gender: Female, Male. Age: 18-64 years, 65+ years. Enrolment: 58.
Status: Authorised, recruitment pending. Decision date: 2025-03-31. Results received: No. Last updated: 2026-08-05.

Condition(s): Cancer, Atherosclerosis
Product: COLCHICINE

Primary endpoint: Change in maximum target-to-background ratio (TBRmax) in coronary arteries, which quantifies 68Gallium-DOTATATE uptake, between baseline and 12-week follow-up on PET-scan.
Endpoint(s): TBRmax in carotid arteries, TBRmax in aorta, Mean standardized uptake value (SUVmean) in spleen, SUVmean in bone marrow, Coronary artery calcium score, Major adverse cardiovascular events (i.e. myocardial infarction, ischemic stroke, ischemia-driven coronary revascularisation, death), All-cause mortality, Immune related adverse events, Biomarkers (e.g. blood inflammatory markers, PBMCs, plasma cytokines, metabolomics, and microbiome composition)

Source: https://euclinicaltrials.eu/ctis-public/view/2024-518100-45-00